EU clinical trial 2024-518840-18-00: A Phase 3a, open-label, randomized, controlled study to evaluate the immunogenicity and safety of intramuscular administration of an investigational varicella vaccine and Priorix compared with subcutaneous administration of Varivax and Priorix, when given as a first dose to healthy children 12 to 15 months of age
Protocol code: 223105
Sponsor: GlaxoSmithKline Biologicals (Pharmaceutical company). Phase: Therapeutic confirmatory (Phase III). Countries: Denmark (authorised, recruitment pending), Poland (ongoing, recruiting), Lithuania (authorised, recruitment pending), Greece (authorised, recruitment pending), Bulgaria (ended), Romania (ongoing, recruiting), Belgium (authorised, recruitment pending), Estonia (ongoing, recruiting).
Therapeutic area(s): Diseases [C] - Virus Diseases [C02]
Gender: Female, Male. Age: 0-17 years. Enrolment: 354.
Start date (EU): 2025-12-10. Decision date: 2025-08-11. Results received: No. Last updated: 2026-08-05.
Decision dates by country: BG: 2025-08-14, DK: 2025-08-11, LT: 2025-08-13, EE: 2025-08-13, BE: 2025-08-12, PL: 2025-08-18, RO: 2025-08-18, GR: 2025-08-14

Condition(s): Varicella
Product: Priorix - Pulver und Lösungsmittel zur Herstellung einer Injektionslösung in einer Fertigspritze|Masern-Mumps-Röteln-Lebendimpfstoff, Priorix - Pulver und Lösungsmittel zur Herstellung einer Injektionslösung in einer Fertigspritze|Masern-Mumps-Röteln-Lebendimpfstoff, VARIVAX® Pulver und Lösungsmittel zur Herstellung einer Injektionssuspension in einer Fertigspritze Varizellen-Lebendimpfstoff, Priorix - Pulver und Lösungsmittel zur Herstellung einer Injektionslösung in einer Fertigspritze|Masern-Mumps-Röteln-Lebendimpfstoff, Priorix - Pulver und Lösungsmittel zur Herstellung einer Injektionslösung in einer Fertigspritze|Masern-Mumps-Röteln-Lebendimpfstoff, Priorix - Pulver und Lösungsmittel zur Herstellung einer Injektionslösung in einer Fertigspritze Masern-Mumps-Röteln-Lebendimpfstoff

Primary endpoint: Seroresponse to VZV gE at Day 43., Anti-VZV gE IgG concentration at Day 43., Seroresponse to MMR antigens at Day 43., Anti-measles, anti-mumps, and anti-rubella IgG concentration at Day 43.
Endpoint(s): Seroresponse to MMR antigens at Day 43., Percentage of participants reporting each solicited administration site event in terms of injection site redness, pain, and swelling within 4 days (Day 1 to Day 4) post-dose of VNS vaccine or VV administration., Percentage of participants reporting each solicited administration site event in terms of injection site redness, pain, and swelling within 4 days (Day 1 to Day 4) post-dose of MMR vaccine administration., Percentage of participants reporting each solicited systemic event in terms of drowsiness, loss of appetite, and irritability within 15 days (Day 1 to Day 15) post-dose of study interventions administration., Percentage of participants reporting each solicited systemic event in terms of fever within 22 days (Day 1 to Day 22) post-dose of study interventions administration., Percentage of participants reporting each solicited administration site and systemic event in terms of injection site varicella-like rash, varicella-like rash (non-injection site), measles/rubella-like rash, and general rash (not varicella-like and not measles/rubella like) within 43 days (Day 1 to Day 43) post dose of study interventions administration as assessed by the investigator, Unsolicited adverse events (AEs) • Percentage of participants reporting unsolicited AEs within 43 days (Day 1 to Day 43) post-dose of study interventions administration., Medically attended AEs (MAAEs) • Percentage of participants reporting MAAEs from Day 1 post-dose of study interventions administration up to study end (Day 181)., Serious adverse events (SAEs) • Percentage of participants reporting SAEs from Day 1 post-dose of study interventions administration up to study end (Day 181)

Source: https://euclinicaltrials.eu/ctis-public/view/2024-518840-18-00